EU clinical trial 2022-502361-15-00: An Open-Label, Multi-Center Extension Study to Characterize the Long-Term Safety and Efficacy of BMS-986165 in Subjects with Moderate-to-Severe Plaque Psoriasis
Protocol code: IM011-075
Sponsor: Bristol-Myers Squibb Services Unlimited Company (Pharmaceutical company). Phase: Therapeutic confirmatory (Phase III). Countries: Hungary (ended), Germany (ended), Sweden (ended), France (ended), Poland (ended), Finland (ended), Spain (ended), Czechia (ended).
Therapeutic area(s): Diseases [C] - Skin and Connective Tissue Diseases [C17]
Gender: Female, Male. Age: 18-64 years, 65+ years. Enrolment: 664.
Status: Ended. Start date (EU): 2019-12-12. End date (EU): 2025-07-31. Decision date: 2024-04-05. Results received: No. Last updated: 2025-08-13.
Decision dates by country: FR: 2024-05-21, HU: 2024-04-05, PL: 2024-04-12, CZ: 2024-04-09, ES: 2024-04-09, FI: 2024-04-09, SE: 2024-04-05, DE: 2024-04-10

Condition(s): Moderate-to-Severe Plaque Psoriasis
Product: deucravacitinib, Placebo to match BMS 986165 tablet

Primary endpoint: Adverse events and serious adverse events
Endpoint(s): sPGA 0/1 response, PASI 75 response

Source: https://euclinicaltrials.eu/ctis-public/view/2022-502361-15-00